EU clinical trial 2024-515038-34-00: CHOLINE-2 - Donepezil Versus Non-drug Treatment in Alzheimer's Disease
Protocol code: APHP201183
Sponsor: Assistance Publique Hopitaux De Paris (Hospital/Clinic/Other health care facility). Phase: Therapeutic use (Phase IV). Countries: France (ongoing, recruiting).
Therapeutic area(s): Diseases [C] - Nervous System Diseases [C10]
Gender: Female, Male. Age: 18-64 years, 65+ years. Enrolment: 240.
Status: Ongoing, recruiting. Start date (EU): 2022-02-10. Decision date: 2024-10-24. Results received: No. Last updated: 2026-04-01.

Condition(s): Interest of adding donepezil to the non-medicinal care pathway recommended in France for Alzheimer's disease
Product: DONEPEZIL, DONEPEZIL

Primary endpoint: Difference in MMSE score between inclusion and 6 months, in the arm treated with donepezil and the usual course of care arm.
Endpoint(s): Difference at 6 months in scores, ADAS-Cog, CDR, ADCS-ADL, quality of life, ZARIT.

Source: https://euclinicaltrials.eu/ctis-public/view/2024-515038-34-00